EU clinical trial 2023-507702-13-00: A Phase 1/2 Study of Oral Selpercatinib (LOXO-292) in Patients with Advanced Solid Tumors, Including RET Fusion-Positive Solid Tumors, Medullary Thyroid Cancer, and Other Tumors with RET Activation (LIBRETTO-001).
Protocol code: LOXO-RET-17001
Sponsor: Loxo Oncology Inc. (Pharmaceutical company). Phase: Phase I and Phase II (Integrated)- First administration to humans. Countries: Spain (ongoing, recruitment ended), France (ongoing, recruitment ended), Germany (ongoing, recruitment ended), Italy (ongoing, recruitment ended), Denmark (ongoing, recruitment ended).
Therapeutic area(s): Diseases [C] - Neoplasms [C04]
Gender: Female, Male. Age: 0-17 years, 18-64 years, 65+ years. Enrolment: 128.
Status: Ongoing, recruitment ended. Start date (EU): 2017-09-22. Decision date: 2024-04-09. Results received: No. Last updated: 2026-06-12.
Decision dates by country: ES: 2024-04-15, DE: 2024-04-10, FR: 2024-04-15, DK: 2024-04-09, IT: 2024-05-13

Condition(s): Male or female patients age 12 years or older with a locally advanced or metastatic solid tumor with evidence of a RET gene alteration in tumor and/or blood.
Product: SELPERCATINIB, SELPERCATINIB

Primary endpoint: 1. Phase 1: MTD/RP2D., 2. Phase 2: ORR based on RECIST 1.1 or RANO, as appropriate to tumor type, assessed by IRC.

Source: https://euclinicaltrials.eu/ctis-public/view/2023-507702-13-00